EU clinical trial 2024-517945-14-00: Single-blinded randomized investigator-initiated controlled trial to assess the efficacy of colchicine to treat patients with cardiomyopathy with myocarditis (chronic inflammatory cardiomyopathy) – Trial and Registry to study the role of genotype environment interaction in Chronic myocarditis and inflammatory cardiomyopathies with ventricular pro-arrhythmic and heart failure phenotypes (PNRR-MAD-2022-12376225)
Protocol code: CMP-MYTHiC
Sponsor: ASST Grande Ospedale Metropolitano Niguarda (Hospital/Clinic/Other health care facility). Phase: Therapeutic confirmatory (Phase III). Countries: Italy (authorised, recruitment pending).
Therapeutic area(s): Diseases [C] - Cardiovascular Diseases [C14]
Gender: Female, Male. Age: 18-64 years, 65+ years. Enrolment: 80.
Status: Authorised, recruitment pending. Decision date: 2024-10-28. Results received: No. Last updated: 2026-05-06.

Condition(s): Inflammatory cardiomyopathy
Product: Tablet composed of Lactose, Sucrose, arabic Gum, Magnesium stearate, COLCHICINA LIRCA 1 mg compresse, COLCHICINA LIRCA 0.5 mg compresse

Primary endpoint: Proportion of patients that are alive and free of any worsening (clinical, arrhythmic burden and imaging outcome) and that shows at least one of the signs of improvements (IMAGING or ARRHYTMIC improvements) at 6 months from randomization, Clinical worsening is defined as the occurrence of at least one of the following events: 1. cardiac death, 2. hospitalization for worsening HF or arrhythmic events, and 3. Occurrence of sustained ventricular tachycardia (SVT), Worsening arrhythmic burden is defined as the occurrence of at least one of the following events: 1. a PVC burden increase of 50% on ECG ambulatory monitoring OR 2. an increase in the number of non-sustained ventricular tachycardia (NSVT) of 30% compared with baseline OR 3. Any SVT recorded in the follow-up., Worsening imaging outcomes is defined as the occurrence of at least one of the following events: 1. a reduction in LVEF >10% on a 6-month follow-up echocardiogram or CMRI, 2. the appearance of new areas of edema on CMRI or FDG-PET associated with an increase in the edema in the inflammatory lesion identified on baseline CMRI or FDGPET., IMPROVEMENT OF IMAGING OUTCOME is defined as the occurrence of at least one of the following events: 1. Reduction of edema on CMRI or FDG uptake without the appearance of new areas of edema on CMRI/FDG-PET and high sensitivity troponin in the normal range 2. The disappearance of edema on CMRI or NO FDG uptake on PET (if present on the baseline), IMPROVEMENT OF ARRHYTHMIC OUTCOME is defined as the occurrence of PVC burden reduction of 70% on the ECG ambulatory monitoring without evidence of NSVT or SVT at 6 months compared with the baseline ambulatory monitoring
Endpoint(s): Absolute change at 6 months from randomization of the left ventricular (LV) ejection fraction (EF) on echocardiogram. Patients not performing the CMRI due to death, heart transplantation (HTx) will be counted as -10 point in the LVEF, Absolute change at 6 months from randomization of the LVEF on CMRI when available. Patients not performing the CMRI due to death, heart transplantation (HTx), LV assist device (LVAD) implantation or device implantation after randomization (i.e. pacemaker [PM] or implantable cardioverter defibrillator [ICD]) will be counted as -10 point in the LVEF, Proportion of patients with LVEF<55% AND/OR LV dilation on 6-month CMRI (CMRI clips will be centrally reviewed) or not performing the CMRI due to death, HTx, LVAD implantation or device implantation after randomization (i.e. PM or ICD), Composite endpoint defined as the time from randomization to the first event occurring within 6 months: all-cause death or HTx or long-term LVAD implantation, or first rehospitalization due to HF or VA, or advanced atrioventricular (AV) block, Mortality: time from randomization to all-cause death within 6 months, Time from randomization to hospitalization for HF/VA or advanced AV block within 6 months, Composite endpoint of presence of NSVT OR increased burden of PVCs (>5% ) on 24-hour ECG ambulatory monitoring, performed at 6- months, Changes in quality of life and health assessment at 6 months follow up compared with baseline using 2 different questionnaires: the EuroQoL 5-dimension, 5-level questionnaire (EoQ-5D) and Kansas City Cardiomyopathy Questionnaire (KCCQ – clinical summary scale and overall summary scale), Need to initiate an immunosuppressive drug (i.e. corticosteroids)

Source: https://euclinicaltrials.eu/ctis-public/view/2024-517945-14-00